EU clinical trial 2023-504146-60-00: A two-stage double-blind, randomized, placebo-controlled study to assess the efficacy, safety and pharmacokinetics of alpelisib in pediatric and adult patients with lymphatic malformations associated with a PIK3CA mutation
Protocol code: CBYL719P12201
Sponsor: Novartis Pharma AG (Pharmaceutical company). Phase: Phase II and Phase III (Integrated). Countries: France (ongoing, recruiting), Italy (ongoing, recruiting), Germany (ongoing, recruiting), Spain (ongoing, recruiting), Belgium (ongoing, recruiting), Netherlands (ongoing, recruiting), Czechia (authorised, recruitment pending).
Therapeutic area(s): Diseases [C] - Hemic and Lymphatic Diseases [C15]
Gender: Female, Male. Age: 0-17 years, 18-64 years, 65+ years. Enrolment: 162.
Start date (EU): 2024-02-07. Decision date: 2024-01-10. Results received: No. Last updated: 2026-07-13.
Decision dates by country: FR: 2024-01-10, DE: 2024-01-11, IT: 2024-01-12, ES: 2024-01-11, BE: 2024-03-26, CZ: 2026-05-13, NL: 2024-04-10

Condition(s): lymphatic malformations associated with PIK3CA mutation
Product: BYL719, Placebo to BYL719 125 mg film-coated tablets, BYL719, BYL719, BYL719, BYL719, Placebo to BYL719 50 mg film-coated tablets, Placebo to BYL719 200 mg film-coated tablets

Primary endpoint: Response (yes/no) at Week 24 (confirmatory phase) of Stage 2, defined by achieving at least 20% reduction in the sum of target lesion volumes (1 to 3 lesions), assessed by MRI by a blinded independent review committee (BIRC) at Week 24, provided that none of the individual target lesions has at least 20% increase from baseline and in absence of progression of non-target lesions and without new lesions.
Endpoint(s): Response (yes/no) at Week 24 (confirmatory phase) of Stage 2 defined by achieving at least a 1-point improvement compared to baseline on the patient global impression of severity (PGI-S) scale., Response at Week 24 of Stage 2, defined by achieving at least 20% reduction in the sum of target lesion volumes (1 to 3 lesions), assessed by MRI by a BIRC at Week 24, provided that none of the individual target lesions has at least 20% increase from baseline and in absence of progression of non-target lesions and without new lesions.

Source: https://euclinicaltrials.eu/ctis-public/view/2023-504146-60-00